EU clinical trial 2024-517971-19-01: Prospective, monocentric, exploratory phase II study for the evaluation of the diagnostic use of the tracer PET (18F) -Flutemetamol (Vizamyl®) in patients with cardiac amyloidosis
Protocol code: PULSAR
Sponsor: Fondazione Toscana Gabriele Monasterio (Patient organisation/association). Phase: Therapeutic exploratory (Phase II). Countries: Italy (ended).
Therapeutic area(s): Diseases [C] - Cardiovascular Diseases [C14]
Gender: Female, Male. Age: 18-64 years, 65+ years. Enrolment: 45.
Status: Ended. Start date (EU): 2023-09-20. End date (EU): 2025-12-31. Decision date: 2024-11-25. Results received: Yes. Last updated: 2024-11-25.

Condition(s): cardiac amyloidosis
Product: VIZAMYL 400 MBq/mL solution for injection

Primary endpoint: Quantification by PET parameters of myocardial uptake of the tracer in patients with cardiac amyloidosis ATTRwt, ATTRv and AL.
Endpoint(s): Quantification of myocardial uptake of the tracer in patients with ATTRv, in patients with ATTRwt, in patients with AL and in control subjects, Quantitative differentiation of myocardial tracer uptake in patients with different ATTRv genotypes, Quantification of myocardial uptake of the tracer in patients with ATTR and weakly positive or negative scintigraphy (Perugini 0–1), Identification and quantification of any areas of systemic uptake of the radiopharmaceutical referred to the presence of amyloid deposits (systemic amyloidosis)

Source: https://euclinicaltrials.eu/ctis-public/view/2024-517971-19-01